EU clinical trial 2023-509879-16-00: Normal saline versus lactated Ringer’s solution for acute pancreatitis resuscitation, an open-label multicenter randomized controlled trial: the WATERLAND trial
Protocol code: WATERLAND
Sponsor: Hospital General Universitario Dr. Balmis (Hospital/Clinic/Other health care facility). Phase: Therapeutic use (Phase IV). Countries: Spain (ended), France (not authorised).
Therapeutic area(s): Diseases [C] - Digestive System Diseases [C06]
Gender: Female, Male. Age: 18-64 years, 65+ years. Enrolment: 100.
Status: Ended. End date (EU): 2024-08-30. Decision date: 2024-01-11. Results received: No. Last updated: 2024-05-17.

Condition(s): Acute pancreatitis
Product: Salina Fisiológica Grifols 0,9% Solución para perfusión Cloruro de sodio, Freeflex Ringer Lactato solución para perfusión

Primary endpoint: The primary outcome will be moderately severe to severe AP, according to the RAC. (Atlanta classification) within the first 30 days after randomization.
Endpoint(s): Local complications (specific complications will be also recorded) Necrotizing pancreatitis SIRS Number of SIRS criteria PAN-PROMISE symptom scale Time to oral refeeding Invasive treatment Nutritional support Intensive care unit admission Exacerbation of coexisting condition Any organ failure Persistent organ failure Shock Respiratory failure Kidney failure Death Hospital stay C-reactive protein

Source: https://euclinicaltrials.eu/ctis-public/view/2023-509879-16-00